EU clinical trial 2025-520558-12-00: A Study to Learn How Different Amounts of the Study Medicine Called PF-07940369 are Tolerated and Act in the Body in Healthy Adults
Protocol code: C5381002
Sponsor: Pfizer Inc. (Pharmaceutical company). Phase: Human Pharmacology (Phase I)- Other. Countries: Belgium (ended).
Therapeutic area(s): Diseases [C] - Hemic and Lymphatic Diseases [C15]
Gender: Female, Male. Age: 18-64 years, 65+ years. Enrolment: 56.
Status: Ended. Start date (EU): 2025-07-09. End date (EU): 2026-01-06. End date: 2026-01-07. Decision date: 2025-07-02. Results received: No. Last updated: 2025-07-30.

Condition(s): Clonal hematopoiesis

Source: https://euclinicaltrials.eu/ctis-public/view/2025-520558-12-00